EU clinical trial 2022-500228-31-01: A 2-stage, Adaptive, Randomised, Double-blind, Placebo-controlled, Multicentre Study to Evaluate Dose and Treatment Effect of Pentosan Polysulfate Sodium Compared with Placebo in Participants with Knee Osteoarthritis Pain
Protocol code: PARA_OA_002
Sponsor: Paradigm Biopharmaceuticals (USA) Inc. (Pharmaceutical company). Phase: Phase II and Phase III (Integrated). Countries: Czechia (ended), Belgium (ended), Poland (ended).
Therapeutic area(s): Diseases [C] - Musculoskeletal Diseases [C05]
Gender: Female, Male. Age: 18-64 years, 65+ years. Enrolment: 80.
Status: Ended. Start date (EU): 2023-03-31. End date (EU): 2023-11-09. Decision date: 2023-02-23. Results received: Yes. Last updated: 2023-03-03.
Decision dates by country: CZ: 2023-03-03, BE: 2023-02-23, PL: 2023-03-01

Condition(s): Knee osteoarthritis pain
Product: Synacthen 0,25 mg/ml oplossing voor injectie, Sodium Chloride 0.9% w/v for injection, Paracetamol Aurovitas, 500 mg, tabletki, Paracetamol Teva 500 mg Tabletten, PARALEN 500 mg tablety, Pentosan polysulfate sodium, Panadol Novum 500 mg potahované tablety, Paracetamol Biofarm, 500 mg, tabletki, Paracetamol Accord, 500 mg, tabletki

Primary endpoint: Change from baseline at Day 56 in knee pain as assessed by the average pain subscale score of the Western Ontario and McMaster Universities (Osteoarthritis Index) (WOMAC®) Numeric Rating Scale (NRS) 3.1 Index., Change from baseline at Day 56 in function as assessed by the average functional subscale score of the WOMAC® NRS 3.1 Index for EMA/MHRA, function will be included as a co-primary endpoint, but still tested in hierarchical order).
Endpoint(s): Change from baseline at Day 56 in function as assessed by the average functional subscale score of the WOMAC® NRS 3.1 Index for EMA/MHRA, function will be included as a co-primary endpoint, but still tested in hierarchical order).Function will be a key secondary in the United States, Change from baseline at Day 84 in knee pain as assessed by the average pain subscale score of the WOMAC® NRS 3.1 Index., Change from baseline at Day 84 in function as assessed by the average functional subscale score of the WOMAC® NRS 3.1 Index.

Source: https://euclinicaltrials.eu/ctis-public/view/2022-500228-31-01